EU clinical trial 2024-514913-37-00: Effectiveness of an Optimisation Strategy for Emergency Tracheal Intubation on postintubation Morbidity: A superiority cluster randomised controlled trial - OSETIM
Protocol code: CHUBX 2021/25
Sponsor: Centre Hospitalier Universitaire De Bordeaux (Hospital/Clinic/Other health care facility). Phase: Phase III and phase IV (Integrated). Countries: France (ongoing, recruiting).
Therapeutic area(s): Diseases [C] - Respiratory Tract Diseases [C08]
Gender: Female, Male. Age: 18-64 years, 65+ years. Enrolment: 1500.
Status: Ongoing, recruiting. Start date (EU): 2023-01-12. Decision date: 2024-09-12. Results received: No. Last updated: 2025-09-03.

Condition(s): Respiratory distress
Product: CELOCURINE 50 mg/ml, solution injectable, SUGAMMADEX JUTA PHARMA 100 mg/mL, solution injectable, ROCURONIUM VIATRIS 10 mg/mL, solution injectable/pour perfusion

Primary endpoint: proportion of patients with severe intubation-related complications occurring during the first hour after intubation. Severe intubation-related complications are: Cardiac arrest. At least one arterial hypotension episode defined by systolic blood pressure<90 mmHg. At least one hypoxemia episode defined by an occurrence of a new episode of oxygen saturation<90%. Severe cardiac arrhythmia: ventricular tachycardia. Pulmonary aspiration. Esophageal intubation. Unintentional extubation.
Endpoint(s): Difficulty of the intubation process: Intubation Difficulty Score: Intubation Difficulty Score > 5 defining difficult intubation.18, Difficulty of the intubation process: Intubation conditions assessed by the Copenhagen score19: Poor conditions/Good conditions/Excellent conditions, Difficulty of the intubation process: Proportion of patients intubated by alternative techniques (stylet, gum elastic bougie, Intubating Laryngeal Mask Airway (ILMA) [e.g., Fastrach], or cricothyrotomy), Difficulty of the intubation process: Mean number of intubation attempts, Difficulty of the intubation process: Mean number of intubation failures under direct laryngoscopy, Out-of hospital care: Mean time of out-of-hospital care (in minutes), defined from time of SMUR arrival on scene to time of hospitalization, Out-of hospital care: Mean total amount of sedative drugs used after intubation, Out-of hospital care: Mean total amount of vasopressors used after intubation, Out-of hospital care: Out-of-hospital mortality, defined as the proportion of patients who died during the out-of-hospital time, Mortality at 28 days: The follow-up of patients stopping at hospital admission, the vital status of the patient will be retrieved using the open-access French Register of deceased persons ("Fichier des personnes décédées") maintained by INSEE (website: https://deces.matchid.io/search)

Source: https://euclinicaltrials.eu/ctis-public/view/2024-514913-37-00